EU clinical trial 2023-503683-16-00: A study to investigate the safety, tolerability, pharmacokinetics, and early signs of biological activity of danegaptide following oral administration in participants with diabetic macular edema
Protocol code: Breye-C22-1005
Sponsor: Breye Therapeutics ApS (Pharmaceutical company). Phase: Human Pharmacology (Phase I)- Other. Countries: Germany (ended).
Therapeutic area(s): Diseases [C] - Eye Diseases [C11]
Gender: Female, Male. Age: 18-64 years, 65+ years. Enrolment: 3.
Status: Ended. Start date (EU): 2023-10-16. End date (EU): 2025-05-28. End date: 2025-05-29. Decision date: 2023-08-10. Results received: No. Last updated: 2025-01-21.

Condition(s): Diabetic macular edema

Source: https://euclinicaltrials.eu/ctis-public/view/2023-503683-16-00